EU clinical trial 2022-501172-25-00: A Randomized, Double-blind, Parallel-group, Active Controlled Trial with Open-label Safety Extension to Evaluate the Tolerability, Safety, and Efficacy of Atogepant versus Topiramate in Subjects Requiring Preventive Treatment of Migraine (TEMPLE)
Protocol code: M22-061
Sponsor: Abbvie Deutschland GmbH & Co. KG (Pharmaceutical company). Phase: Therapeutic confirmatory (Phase III). Countries: Belgium (ended), Austria (ended), Poland (ended), Czechia (ended), Italy (ended), Germany (ended), Hungary (ended), France (ended), Portugal (ended).
Therapeutic area(s): Diseases [C] - Nervous System Diseases [C10]
Gender: Female, Male. Age: 18-64 years, 65+ years. Enrolment: 475.
Status: Ended. Start date (EU): 2024-01-17. End date (EU): 2026-05-27. End date: 2026-06-03. Decision date: 2023-09-08. Results received: No. Last updated: 2026-06-30.
Decision dates by country: IT: 2023-09-08, BE: 2023-09-11, CZ: 2023-09-08, PL: 2023-09-12, DE: 2023-09-08, AT: 2023-09-12, HU: 2023-09-12, FR: 2023-09-08, PT: 2023-09-08

Condition(s): Chronic and Episodic Migraine
Product: Placebo for atogepant tablets 60mg, Atogepant, TOPIRAMATE, Placebo for topiramate capsules 25mg and 50mg, TOPIRAMATE

Primary endpoint: The primary endpoint is treatment discontinuation due to AEs during the 24-week DB treatment period
Endpoint(s): Achievement of ≥ 50% improvement (reduction) in mean MMD during Months 4 to 6 of the DB treatment period., Change from baseline in mean MMD during Months 4 to 6 of the DB treatment period, Change from baseline in HIT-6 total score at Week 24, Change from baseline in MSQ Version 2.1 RFR domain score at Week 24, Achievement of a rating of "much better" or "very much better" at Week 24 assessed by the PGIC, Change from baseline in Patient-Reported Outcomes Measurement Information System (PROMIS) Cognitive Function –Abilities Subset –Short Form 6a Version 2.0 score at Week 6

Source: https://euclinicaltrials.eu/ctis-public/view/2022-501172-25-00